EU clinical trial 2024-515047-31-00: A Randomized, Double-Blind, International Multicenter, Phase III Study to Evaluate the Anti-Tumor Efficacy and Safety of HLX10 (Recombinant Humanized Anti-PD-1 Monoclonal Antibody Injection) or Placebo in Combination with Chemotherapy (Carboplatin/Cisplatin-Etoposide) and Concurrent Radiotherapy in Patients with Limited-Stage Small Cell Lung Cancer (LS-SCLC)
Protocol code: HLX10-020-SCLC302
Sponsor: Shanghai Henlius Biotech Inc. (Pharmaceutical company). Phase: Therapeutic confirmatory (Phase III). Countries: Czechia (ongoing, recruitment ended), Austria (ongoing, recruitment ended), Spain (ongoing, recruitment ended), Germany (ongoing, recruitment ended), Netherlands (ongoing, recruitment ended), Latvia (ongoing, recruitment ended), Hungary (ongoing, recruitment ended), Greece (ongoing, recruitment ended), Poland (ongoing, recruitment ended).
Therapeutic area(s): Diseases [C] - Neoplasms [C04]
Gender: Female, Male. Age: 18-64 years, 65+ years. Enrolment: 111.
Status: Ongoing, recruitment ended. Start date (EU): 2023-08-28. Decision date: 2024-08-23. Results received: No. Last updated: 2026-05-13.
Decision dates by country: NL: 2024-08-23, AT: 2024-09-02, LV: 2024-08-26, CZ: 2024-08-28, DE: 2024-08-28, HU: 2024-08-27, PL: 2024-10-05, ES: 2024-09-05, GR: 2024-11-13

Condition(s): Patients with Limited-Stage Small Cell Lung Cancer (LS-SCLC) at stage I-III of the AJCC 8th edition of the cancer staging
Product: HLX10 placebo, Serplulimab

Primary endpoint: Overall survival (OS), Progression-free survival (PFS) [assessed by the Blinded Independent Central Review (BICR) as per RECIST v1.1]
Endpoint(s): Objective response rate (ORR) (assessed by the BICR and investigator as per RECIST 1.1), Duration of response (DOR) (assessed by the BICR and investigator as per RECIST 1.1), Adverse events (AE) (including serious adverse events (SAE))laboratory tests (hematology, blood chemistry, coagulation function, urinalysis, thyroid function, and cardiac function), 12-lead electrocardiogram (12-lead ECG), vital signs, and physical examination, Quality of life assessment, Serum HLX10 concentration, HLX10 anti-drug antibody/neutralizing antibody (ADA/NAb), Relationship between PD-L1 expression in tumor tissuesand efficacy, PFS assessed by the investigator as per RECIST v1.1

Source: https://euclinicaltrials.eu/ctis-public/view/2024-515047-31-00